EU clinical trial 2024-520030-30-00: A pilot study for optimizing meropenem administration in the intensive care unit – short six times vs. prolonged three times courses daily
Protocol code: Mer-6
Sponsor: Oslo University Hospital HF (Hospital/Clinic/Other health care facility). Phase: Therapeutic confirmatory (Phase III). Countries: Norway (ongoing, recruiting).
Therapeutic area(s): Diseases [C] - Bacterial Infections and Mycoses [C01]
Gender: Female, Male. Age: 18-64 years, 65+ years. Enrolment: 50.
Status: Ongoing, recruiting. Start date (EU): 2025-01-23. Decision date: 2025-01-23. Results received: No. Last updated: 2025-01-23.

Condition(s): Serious infection requiring broad-spectrum antibiotic
Product: MEROPENEM

Primary endpoint: Proportion of patients who achieve adequate meropenem concentration (>2 mg/l) > 50% of the time per day (50% T>MIC) when dosing with more frequent and shorter infusions after 1, 2 and 3 days
Endpoint(s): Proportion of patients who achieve adequate meropenem concentration (>2 mg/l) > 100% of the time per day (50% T>MIC) when dosing with more frequent and shorter infusions after 1, 2 and 3 days, Lenght of stay in the intensive care unit., Mortality 30 days after admission to the intensive care unit., Serious adverse events

Source: https://euclinicaltrials.eu/ctis-public/view/2024-520030-30-00